EU clinical trial 2026-526859-54-00: A Randomised, Placebo‑Controlled Trial to Assess Effect of IMU‑838 on QT/QTc
Protocol code: P1-IMU-838-ECG
Sponsor: Immunic AG (Pharmaceutical company). Phase: Human Pharmacology (Phase I)- Other. Countries: Belgium (ongoing, recruiting).
Therapeutic area(s): Diseases [C] - Nervous System Diseases [C10]
Gender: Female, Male. Age: 18-64 years. Enrolment: 20.
Status: Ongoing, recruiting. Start date (EU): 2026-08-05. Decision date: 2026-07-31. Results received: No. Last updated: 2026-07-31.

Condition(s): Multiple sclerosis

Source: https://euclinicaltrials.eu/ctis-public/view/2026-526859-54-00